EU clinical trial 2024-513426-29-00: International prospective Phase 2 trial addressing the efficacy of first-line Chlamydophila psittaci-eradicating therapy with protracted administration of doxycycline followed by eradication monitoring and antibiotic re-treatment at infection re-occurrence in patients with newly diagnosed Ocular Adnexal Marginal Zone Lymphoma (OAMZL)
Protocol code: IELSG39
Sponsor: Association International Extranodal Lymphoma Study Group (IELSG) (Laboratory/Research/Testing facility). Phase: Therapeutic exploratory (Phase II). Countries: Italy (ended).
Therapeutic area(s): Diseases [C] - Hemic and Lymphatic Diseases [C15]
Gender: Female, Male. Age: 18-64 years, 65+ years. Enrolment: 44.
Status: Ended. Start date (EU): 2013-03-19. End date (EU): 2026-04-01. Decision date: 2025-01-13. Results received: No. Last updated: 2025-08-26.

Condition(s): Patients with newly diagnosed Ocular Adnexal Marginal Zone Lymphoma (OAMZL)
Product: DOXYCYCLINE

Primary endpoint: The primary endpoint is the 2-year progression-free survival (PFS) of patients with newly diagnosed stage-IE OAMZL treated with the experimental strategy
Endpoint(s): Feasibility, Tolerability of prolonged administration of doxycycline, Activity (overall response rate), Overall survival, Cp eradication rate, Infection re-occurrence rate, Assessment of prevalence of IRTA1 marker in OAMZL, Assessment of genetic lesions and gene expression changes in OAMZL and their possible relationship with Cp infection and response to treatment, Identification of possible SNPs associated with Cp infection in OAMZL patients, Identification of possible bacterial polymorphisms responsible for antibiotic resistance, infection recurrence or persistence

Source: https://euclinicaltrials.eu/ctis-public/view/2024-513426-29-00